EU clinical trial 2024-513064-26-00: An open label, multi-centric trial to assess the safety and efficacy of an Esflurbiprofen Topical System (EFTS) in the local symptomatic and short-term treatment of pain in contusions.
Protocol code: TK-254RX-0302
Sponsor: Teikoku Seiyaku Co. Ltd. (Pharmaceutical company). Phase: Therapeutic confirmatory (Phase III). Countries: Germany (ended).
Therapeutic area(s): Diseases [C] - Musculoskeletal Diseases [C05]
Gender: Female, Male. Age: 18-64 years. Enrolment: 219.
Status: Ended. Start date (EU): 2025-02-12. End date (EU): 2025-10-01. Decision date: 2024-10-07. Results received: No. Last updated: 2025-09-15.
Decision dates by country: DE: 2024-12-17

Condition(s): acute contusion of the upper or lower limbs
Product: Esflurbiprofen Topical System (EFTS), PARACETAMOL

Primary endpoint: Adverse events (AEs)
Endpoint(s): VAS score on POM at before bed time on Day 1, 24, 48, 72, 96, 120, 168 h and related PIDs and SPIDs, VAS score on PAR at before bed time on Day 1, 24, 48, 72, 96, 120, 168 h and related PIDs and SPIDs, Time to meaningful/optimal reduction of pain defined as 30 % (meaningful) and 50 % (optimal) reduction of VAS on POM, Time to complete resolution of pain-on-movement defined as POM VAS value of 0 mm, Time to complete resolution of pain-at-rest defined as PAR VAS value of 0 mm, Responder rate 1 (defined as the number of patients achieving at least 50 % reduction from baseline in the VAS score for POM at 48 h), Responder rate 2 (defined as the number of patients able to resume training/normal physical activity by 168 h), Resolution of contusions (defined as the percentage of patients who showed POM=PAR=0 at 168 h), Global efficacy assessments by physician (GEA, 5-point scale: 0=no response; 1=poor response; 2=fair response; 3=good response; 4=excellent response) at 48, 72, and 168 h, Global efficacy assessments by patient (GEA, 5-point scale: 0=no response; 1=poor response; 2=fair response; 3=good response; 4=excellent response) at 48, 72, and 168 h, Use of rescue medication at every visit except Visit 1, Local tolerability (skin damage/reaction according to an 8-point scale) at Visit 6, Adhesive power of the EFTS will be visually assessed and classified by the site staff in a 5-point-score (0=≥ 90 % adhered / 1= ≥75 % to <90 % adhered / 2=≥50 % to <75 % adhered / 3=>0 % to <50 % adhered / 4=completely detached) at Visits 2-5 (24 h after EFTS application), Adhesive power of the EFTS will be visually assessed and classified by the subject in a 5-point-score (0=≥ 90 % adhered / 1= ≥75 % to <90 % adhered / 2=≥50 % to <75 % adhered / 3=>0 % to <50 % adhered / 4=completely detached) at before/after bed time and 24 h after each EFTS application

Source: https://euclinicaltrials.eu/ctis-public/view/2024-513064-26-00